EU clinical trial 2024-517127-40-00: (WHAT!) – RCT: Open-label randomized controlled trial for the effects of continuous daily use of ethinylestradiol/levonorgestrel (30/150 µg/day) compared with vitamin E (400 IU/day) in the treatment of menstrually-related migraine and perimenopausal migraine
Protocol code: P19.040
Sponsor: Leids Universitair Medisch Centrum (LUMC) (Hospital/Clinic/Other health care facility). Phase: Phase III and phase IV (Integrated). Countries: Netherlands (ongoing, recruiting).
Therapeutic area(s): Diseases [C] - Hormonal diseases [C19]; Diseases [C] - Nervous System Diseases [C10]
Gender: Female. Age: 18-64 years. Enrolment: 360.
Status: Ongoing, recruiting. Start date (EU): 2024-11-29. Decision date: 2024-11-29. Results received: No. Last updated: 2026-03-25.

Condition(s): Migraine
Product: Vitamine E-400 complex, Microgynon 30, 0,15 mg/0,03 mg omhulde tabletten

Primary endpoint: mean change from baseline in mean monthly migraine days in a 28-day period as assessed at the 12-week timepoint (weeks 9–12).
Endpoint(s): mean change from baseline in a 28-day period as assessed at the 12-week timepoint (week 9-12): • Number of headache days • Number of migraine or probable migraine attacks • 50% responders, defined as patients who had ≥50% reduction in the number of migraine days.

Source: https://euclinicaltrials.eu/ctis-public/view/2024-517127-40-00